EU clinical trial 2025-524638-24-00: CD5CAR-NK cells for refractory invasive mold disease
Protocol code: CD5CAR-NK
Sponsor: Fundacio De Recerca Clinic Barcelona-Institut D’Investigacions Biomediques August Pi I Sunyer (Laboratory/Research/Testing facility). Phase: Human Pharmacology (Phase I)- First administration to humans. Countries: Spain (ongoing, recruiting).
Therapeutic area(s): Diseases [C] - Bacterial Infections and Mycoses [C01]
Gender: Female, Male. Age: 18-64 years, 65+ years. Enrolment: 10.
Status: Ongoing, recruiting. Start date (EU): 2026-06-17. Decision date: 2026-05-04. Results received: No. Last updated: 2026-05-04.

Condition(s): refractory invasive mold disease

Source: https://euclinicaltrials.eu/ctis-public/view/2025-524638-24-00